EU clinical trial 2023-508071-36-00: RASBU-SEPSIS Study: Effects of rasburicase on renal function during sepsis – a randomized, placebo-controlled, double-blind trial
Protocol code: APHP191099
Sponsor: Assistance Publique Hopitaux De Paris (Hospital/Clinic/Other health care facility). Phase: Therapeutic confirmatory (Phase III). Countries: France (authorised, recruitment pending).
Therapeutic area(s): Diseases [C] - Bacterial Infections and Mycoses [C01]
Gender: Female, Male. Age: 18-64 years, 65+ years. Enrolment: 240.
Status: Authorised, recruitment pending. Decision date: 2025-11-24. Results received: No. Last updated: 2025-11-24.

Condition(s): Patients hospitalised in intensive care, diagnosed with sepsis less than 48 hours ago, uric acid level ≥200µmol/L, adults, negative G6PD deficiency
Product: Placebo de fasturtec, Fasturtec 1.5 mg/ml powder and solvent for concentrate for solution for infusion.

Primary endpoint: Worsening of renal function defined by at least one of the following: • The onset of acute kidney injury (AKI) within 7 days of inclusion. • Non-improvement or progression of the stage of AKI according to KDIGO criteria on the 7th day after inclusion
Endpoint(s): Death rate at D28 and D90, The maximum SOFA score during the first 7 days, The evolution of renal aggression markers (N-GAL, Pro-enkephalin, IL-18) in blood and urine at D0, D3, and D7, The evolution of the leukocyte rate, pro- and anti-inflammatory cytokines (TNFα, IL-1, 6, 8, 10) at D1, D3, and D7

Source: https://euclinicaltrials.eu/ctis-public/view/2023-508071-36-00